EU clinical trial 2025-523875-48-00: Open-labelled, single-centre investigation of safety and tolerability of multiple ascending doses of nebulised SS0331 in healthy participants followed by investigation of preliminary efficacy of nebulised SS0331 in airway-infected patients with chronic airway infections
Protocol code: SIS-03
Sponsor: Softox Solutions AS (Pharmaceutical company). Phase: Phase I and Phase II (Integrated)- Other. Countries: Denmark (ongoing, recruiting).
Therapeutic area(s): Diseases [C] - Virus Diseases [C02]; Diseases [C] - Bacterial Infections and Mycoses [C01]
Gender: Female, Male. Age: 18-64 years. Enrolment: 55.
Status: Ongoing, recruiting. Start date (EU): 2026-02-17. Decision date: 2025-12-19. Results received: No. Last updated: 2026-05-29.

Condition(s): Chronic airway infections

Primary endpoint: Phase 1: The primary endpoint in the dose-escalation part of the trial is the nature, incidence, and severity of adverse events (AEs), Phase 2a: The primary endpoint in the PoC part of the trial is the change from baseline in log10-transformed sputum density of bacteria following treatment

Source: https://euclinicaltrials.eu/ctis-public/view/2025-523875-48-00